EU clinical trial 2024-518688-36-00: The PENTO protocol in Medication-Related Osteonecrosis of the Jaw (MRONJ): a single-center phase IIa trial
Protocol code: 87RI21_0052
Sponsor: Centre Hospitalier Et Universitaire De Limoges (Hospital/Clinic/Other health care facility). Phase: Therapeutic exploratory (Phase II). Countries: France (ongoing, recruiting).
Therapeutic area(s): Diseases [C] - Stomatognathic Diseases [C07]
Gender: Female, Male. Age: 18-64 years, 65+ years. Enrolment: 17.
Status: Ongoing, recruiting. Start date (EU): 2024-02-29. Decision date: 2024-10-29. Results received: No. Last updated: 2026-03-10.

Condition(s): medication-related osteonecrosis of the Jaw
Product: AMOXICILLIN AND BETA-LACTAMASE INHIBITOR, CLINDAMYCIN, TOCOPHEROL (VIT E), PENTOXIFYLLINE

Primary endpoint: The primary endpoint is healing as defined by an exposure bone area (EBA) less than 5 mm at 12 months. It will be expressed as the percentage of patients who achieved healing (EBA < 5 mm) at 12 months.
Endpoint(s): Progression of the modified SOMA score over 12 months: The modified SOMA score will be assessed at patient inclusion and at follow-up visits at 1, 3, 6 and 12 months., Progression of nutritional parameters over 12 months: These parameters are weight (in kg), BMI (in kg/m²), albuminemia (g/L) and pre-albuminemia (mg/L). These parameters will be assessed at patient inclusion and at follow-up visits at 1, 3, 6 and 12 months., 12-month change in EBA (dimension): This endpoint will be assessed quantitatively by the D dimension of EBA, defined as the measurement of the major axis of mucosal loss. This parameter will be assessed at patient inclusion and at follow-up visits at 1, 3, 6 and 12 months. The evolution of EBA corresponds to the relative regression of D defined by (D at x months - D at inclusion)/D at inclusion., All adverse events are collected via questioning and blood pressure measurement at each follow-up visit (at 1-3-6-12 months). Data collected on adverse events will cover their nature, severity (mild, moderate, severe) and causality.

Source: https://euclinicaltrials.eu/ctis-public/view/2024-518688-36-00